EU clinical trial 2026-526212-37-00: Long-term follow-up study of patients who have previously been exposed to UCART19 (allogeneic engineered T-cells expressing a lentiviral-based anti-CD19 chimeric antigen receptor)
Protocol code: CL1-68587-003
Sponsor: Institut De Recherches Internationales Servier IRIS (Pharmaceutical company). Phase: Therapeutic confirmatory (Phase III). Countries: France (authorised, recruitment pending).
Therapeutic area(s): Diseases [C] - Neoplasms [C04]
Gender: Female, Male. Age: 0-17 years, 18-64 years, 65+ years. Enrolment: 1.
Status: Authorised, recruitment pending. Decision date: 2026-06-09. Results received: No. Last updated: 2026-06-09.

Condition(s): Advanced lymphoid leukemia
Product: S68587 - 20 megaCells/ml, S68587 - 15 megaCells/ml, S68587 - 6 megaCells/ml, S68587 - 0.6 megaCells/ml

Primary endpoint: Number, duration, outcome of all adverse events (AE) within 12 months post last UCART19 infusion., Number, duration, outcome of adverse events of special interest (AESI) up to the end of the study., Proportion of patients with adverse events leading to death up to the end of the study., For paediatric patients: assesment of the potential impact on growth curve and puberty.
Endpoint(s): Proportion of patients who relapse or progress., Progression-free survival (PFS), disease specific survival (DSS)., Duration of remission until the date of progression or death due to any cause, whichever occurs first., Overall survival (OS), Proportion of patients who underwent allogeneic HSCT if not transplanted within the parent study., Time to transplant., Measurement of CD19CAR transgene levels by qPCR (and optionally by flow cytometry) in blood, and in bone marrow (if a BM aspirate is collected by the centre as part of the routine care of the patient’s disease).

Source: https://euclinicaltrials.eu/ctis-public/view/2026-526212-37-00